EU clinical trial 2024-515984-68-00: “Phase II clinical trial of chemotherapy + atezolizumab for stage IIIA and IIIB non-small cell lung cancer followed by atezolizumab as adjuvant treatment after surgery and atezolizumab for non-resected patients after chemoradiotherapy” ATHENEA
Protocol code: GECP 23/02
Sponsor: Fundacion GECP (Patient organisation/association). Phase: Therapeutic exploratory (Phase II). Countries: Spain (ongoing, recruiting).
Therapeutic area(s): Diseases [C] - Neoplasms [C04]
Gender: Female, Male. Age: 18-64 years, 65+ years. Enrolment: 97.
Status: Ongoing, recruiting. Start date (EU): 2025-05-20. Decision date: 2025-01-29. Results received: No. Last updated: 2026-06-04.

Condition(s): Non-small cell lung cancer (NSCLC)
Product: Tecentriq 1 200 mg concentrate for solution for infusion, Carboplatino Teva 10 mg/ml Concentrado para solución para perfusión, Paclitaxel Teva 6 mg/ml concentrado para solución para perfusión EFG

Primary endpoint: Evaluate the Progression free survival (PFS) rate at 18 months in the intent-to-treat population. Progression free survival (PFS) defined as the time from initiation of treatment to the occurrence of disease progression or death.
Endpoint(s): 1. Resectability rate (%), 2. Proportion of R0 resections (%), 3. Pathological complete response (pCR) in the intent-to-treat population (ITT), 4. Major Pathological response (MPR) rate, 5. PFS rate at 12 months, 6. PFS rate at 12 and 18 months in patients candidates for surgery and in patients not candidates for surgery with pCR and clinical follow up, 7. PFS rate at 12 and 18 months in patients candidate for surgery and in patients not candidates for surgery with pCR and adjuvant treatment, 8. PFS rate at 12 and 18 months in patients who are candidates for surgery with pCR, 9. PFS rate at 12 and 18 months in patients who are candidates for surgery with No pCR, 10. Overall survival (OS) rate at 12 and 18 months of treatment, 11. OS rate at 12 and 18 months in patients candidates of for surgery and in patients not candidates for surgery with pCR and clinical follow up, 12. OS rate at 12 and 18 months in patients candidate for surgery and in patients not candidates for surgery with pCR and adjuvant treatment, 13. OS rate at 12 and 18 months in patients who are candidates for surgery with pCR, 14. OS rate at 12 and 18 months in patients who are candidates for surgery with no pCR, 15. Downstaging rate (%), 16. To evaluate whether there is a significant association between baseline levels of ctDNA and OS and PFS., 17. To evaluate whether there is a significant association between ctDNA clearance (no detection of ctDNA) after neoadjuvant treatment and OS and PFS., 18. To identify molecular alterations that may lead to treatment failure., 19. To measure minimal residual disease after surgery and evaluate its capacity to predict PFS and OS, 20. To describe the levels, relationships and changes of molecular markers related to the immune response at diagnosis and during treatment, as well as, whether they are predictive for pathological Response, ORR, ctDNA negativization, adverse events, sites of first failure, PFS and OS

Source: https://euclinicaltrials.eu/ctis-public/view/2024-515984-68-00